EU clinical trial 2024-519857-13-00: A PHASE II, SINGLE-CENTER, RANDOMIZED DOUBLE BLIND, PLACEBO CONTROLLED STUDY TO EVALUATE THE EFFECT OF THE COMBINED THERAPY OF EH-301 AND N-ACETYLCYSTEINE TOGETHER WITH RILUZOLE IN AMBULANT PATIENTS DIAGNOSED WITH AMYOTROPHIC LATERAL SCLEROSIS (ALS)
Protocol code: NADALS-001-ALS -2021
Sponsor: Asociacion Instituto Biogipuzkoa (Patient organisation/association). Phase: Phase I and Phase II (Integrated)- Other. Countries: Spain (ongoing, recruiting).
Therapeutic area(s): Diseases [C] - Nervous System Diseases [C10]
Gender: Female, Male. Age: 18-64 years, 65+ years. Enrolment: 90.
Status: Ongoing, recruiting. Start date (EU): 2025-11-25. Decision date: 2025-04-21. Results received: No. Last updated: 2026-03-13.

Condition(s): Amyotrophic Lateral Sclerosis (ALS)
Product: La composición cualitativa y cuantitativa de cada sobre de placebo es la siguiente: Bicarbonato sódico 563,75 mg Diluyente/generador de efervescencia Ph Eur Ácido cítrico 410,0 mg Diluyente/generador de efervescencia Ph Eur Maltodextrina 651,25 mg Diluyente Ph Eur Sílice coloidal anhidra 10,0 mg Fluidificante/desecante interno Ph Eur Manitol 769,0 mg Diluyente Ph Eur; Sacarina sódica 24,0 mg Edulcorante Ph Eur; Aroma de naranja 72,0 mg Saborizante Espec.. interna Masa nominal 2.500 mg El polvo efervescente se envasa en sobres de papel y aluminio con recubrimiento interno de polietileno., RILUZOLE, ACETYLCYSTEINE, ACETYLCYSTEINE

Primary endpoint: Changes in the ALSFRS-R scale., Time to progression of patients suffering a 20% reduction in the ALSFRS-R scale 3.
Endpoint(s): Muscle strength measured by manual dynamometry., Survival., Quality of life measured by the ALSAQ-40 scale., Respiratory function through the percentage of forced capacity (%FVC)., Time elapsed until gastrostomy., Combined assessment of function and survival (CAFS)., Nfl rate in CSF and changes in serum Nfl rate.

Source: https://euclinicaltrials.eu/ctis-public/view/2024-519857-13-00